EU clinical trial 2024-516486-36-00: [68Ga]Ga-FAPI-46 positron emission tomography in pancreatobiliary cancers: a pharmacokinetics, repeatability and diagnostic accuracy study. (PANSCAN-1)
Sponsor: Stichting Amsterdam UMC (Hospital/Clinic/Other health care facility). Phase: Phase II and Phase III (Integrated). Countries: Netherlands (ongoing, recruiting).
Therapeutic area(s): Diseases [C] - Neoplasms [C04]; Analytical, Diagnostic and Therapeutic Techniques and Equipment [E] - Diagnosis [E01]; Diseases [C] - Digestive System Diseases [C06]
Gender: Female, Male. Age: 18-64 years, 65+ years. Enrolment: 63.
Status: Ongoing, recruiting. Start date (EU): 2025-03-24. Decision date: 2024-09-26. Results received: No. Last updated: 2024-09-26.

Condition(s): cholangiocarcinoma (bile duct cancer), pancreatic carcinoma (pancreatic cancer)
Product: GALLIUM (68GA) CHLORIDE

Primary endpoint: Part A: Pharmacokinetic analysis 1. The optimal kinetic model to quantify [68Ga]Ga-FAPI-46 pharmacokinetics and tracer uptake. 2. The most suitable simplified quantitative measurement, as a surrogate for the full kinetic model., Part B: Test-retest variation study 1. The daily variability (average percentage of difference) of the preferred simplified method for quantification of [68Ga]Ga-FAPI-46., Part C: Diagnostic accuracy 1. Per lesion analysis of diagnostic accuracy of [68Ga]Ga-FAPI-46 PET/CT. 2. Diagnostic accuracy of response monitoring using [68Ga]Ga-FAPI-46 PET/CT.
Endpoint(s): Percentage of agreement between tumor uptake on the [68Ga]Ga- FAPI-46 PET/CT scan, histopathologic evidence of tumor, and the expression of FAP (IHC)., Percentage of potential change of therapy management enabled by [68Ga]Ga-FAPI-46 PET/CT, Percentage of agreement between different imaging modalities ([68Ga]Ga-FAPI-46 PET/CT and CT, MRI or FDG PET/CT), Sensitivity of response prediction based on the first [68Ga]Ga-FAPI-46 PET/CT, Accuracy of determining surgical resectability using [68Ga]Ga-FAPI-46 PET/CT., Correlation between [68Ga]Ga-FAPI-46 PET/CT signal to tumor regression (MDACC method), Diagnostic accuracy of incidental findings on [68Ga]Ga-FAPI-46 PET/CT

Source: https://euclinicaltrials.eu/ctis-public/view/2024-516486-36-00